EU clinical trial 2024-512686-13-00: A Phase 1, Open-Label Study of the Safety, Pharmacokinetics, and Pharmacodynamics of JNJ-64264681 in Participants with Non-Hodgkin Lymphoma and Chronic Lymphocytic Leukemia
Protocol code: 64264681LYM1001
Sponsor: Janssen Cilag International (Pharmaceutical company). Phase: Human Pharmacology (Phase I)- Other. Countries: Poland (ended).
Therapeutic area(s): Diseases [C] - Neoplasms [C04]
Gender: Female, Male. Age: 18-64 years, 65+ years. Enrolment: 16.
Status: Ended. Start date (EU): 2021-01-28. End date (EU): 2025-01-29. End date: 2025-05-28. Decision date: 2024-07-09. Results received: No. Last updated: 2024-07-09.

Condition(s): non-Hodgkin lymphoma and chronic lymphocytic leukemia

Source: https://euclinicaltrials.eu/ctis-public/view/2024-512686-13-00